EU clinical trial 2023-509292-17-00: Phase II neoadjuvant study evaluating capivasertib plus fulvestrant vs fulvestrant in patients with primary high-risk lobular breast cancer- LOBSTER
Protocol code: GBG 118
Sponsor: GBG Forschungs GmbH (Hospital/Clinic/Other health care facility). Phase: Therapeutic exploratory (Phase II). Countries: Germany (ongoing, recruiting).
Therapeutic area(s): Diseases [C] - Neoplasms [C04]
Gender: Female. Age: 18-64 years, 65+ years. Enrolment: 120.
Status: Ongoing, recruiting. Start date (EU): 2024-11-08. Decision date: 2024-05-03. Results received: No. Last updated: 2026-07-01.

Condition(s): primary high-risk lobular breast cancer
Product: Faslodex 250 mg solution for injection., Capivasertib

Primary endpoint: The primary endpoint CCCA is defined as Ki67 drop to <2.7% after approximately 10 weeks (will be assessed centrally on the breast tissue submitted to central pathology)
Endpoint(s): Pathological complete response (pCR ypT0 ypN0) is defined as no microscopic evidence of residual invasive and non-invasive viable tumor cells in all resected specimens of the breast and axilla., Pathological complete response (pCR ypT0/is ypN0) is defined as no microscopic evidence of residual invasive viable tumor cells in all resected specimens of the breast and axilla., Pathological response will be assessed considering histological reports of all removed breast and lymphatic tissues from all surgeries; patients in whom pCR cannot be assessed will be counted as no pCR., Invasive disease-free survival (iDFS) is defined as time from randomization until first iDFS event: local invasive recurrence following mastectomy, local invasive recurrence in the ipsilateral breast following lumpectomy, regional recurrence, distant recurrence, contralateral invasive breast cancer, second non-breast primary cancer (excluding squamous or basal cell carcinoma of the skin), or death from any cause., Overall survival OS is defined as time from randomization until death due to any cause.

Source: https://euclinicaltrials.eu/ctis-public/view/2023-509292-17-00